EU clinical trial 2024-512553-25-00: MCA-derived MSC therapy in renal transplant recipients
Sponsor: Leids Universitair Medisch Centrum (LUMC) (Hospital/Clinic/Other health care facility). Phase: Human Pharmacology (Phase I)- Other. Countries: Netherlands (ongoing, recruiting).
Therapeutic area(s): Phenomena and Processes [G] - Immune system processes [G12]
Gender: Female, Male. Age: 18-64 years, 65+ years. Enrolment: 16.
Status: Ongoing, recruiting. Start date (EU): 2024-10-15. Decision date: 2024-09-30. Results received: No. Last updated: 2025-12-08.

Condition(s): Rejection transplanted kidney, BPAR

Source: https://euclinicaltrials.eu/ctis-public/view/2024-512553-25-00